EU clinical trial 2024-511720-13-00: COVARIAN : Contribution of contrast enhanced ultrasound for diagnosis of adnexal torsion: a randomized controlled trial
Protocol code: 2021PI162
Sponsor: CHRU De Nancy (Hospital/Clinic/Other health care facility). Phase: Therapeutic confirmatory (Phase III). Countries: France (ongoing, recruiting).
Therapeutic area(s): Analytical, Diagnostic and Therapeutic Techniques and Equipment [E] - Diagnosis [E01]
Gender: Female. Age: 18-64 years, 65+ years. Enrolment: 256.
Status: Ongoing, recruiting. Start date (EU): 2025-05-14. Decision date: 2024-10-28. Results received: No. Last updated: 2025-06-30.

Condition(s): adnexal torsion
Product: SonoVue 8 microlitres/mL powder and solvent for dispersion for injection

Primary endpoint: Percentage of surgical procedures performed in emergency (within 6 hours of arrival of the patient) without proven torsion (no visible spiral turn in intraoperative) in each group.
Endpoint(s): To meet secondary objective #1: Rate of hospitalization and rate of consultation at 1 month, pain at 7 days evaluated by a numerical scale, rate of secondary surgery with proven torsion at 1 month, rate of complications (pelvic abscess, pelviperitonitis, necrotic aspect of the ovary, non conservative treatment) at 1 month., To meet secondary objective #2: -Length of hospitalization expressed in hours or days, -Collection of intraoperative complications (during hospitalization): hemorrhage, vascular wound, digestive wound, -Collection of postoperative complications at 1 month: secondary hemorrhage, surgical resumption (whatever the reason), scar disunity, scar abscess, -Hospitalization rate and consultation rate at 1 month, -7-day pain assessed by numerical scale., To meet secondary objective #3: Incidence of serious adverse events within 30 minutes of injection of SonoVue® and collection of any delayed hypersensitivity manifestations (skin, respiratory)., To meet secondary objective #4:Quantitative and qualitative data from the process evaluation will be compared to identify and remove potential obstacles to the use of contrast ultrasound in cases of suspected adnexal torsion.

Source: https://euclinicaltrials.eu/ctis-public/view/2024-511720-13-00